EU clinical trial 2024-511842-38-00: The BioFINDER 2 study - improved diagnostics and increased understanding of the pathophysiology of cognitive disorders
Sponsor: Region Skane (Hospital/Clinic/Other health care facility). Phase: Therapeutic exploratory (Phase II). Countries: Sweden (ongoing, recruiting).
Therapeutic area(s): Analytical, Diagnostic and Therapeutic Techniques and Equipment [E] - Diagnosis [E01]
Gender: Female, Male. Age: 18-64 years, 65+ years. Enrolment: 2450.
Status: Ongoing, recruiting. Start date (EU): 2017-04-10. Decision date: 2024-09-18. Results received: No. Last updated: 2024-09-18.

Condition(s): Neurodegenerative disorders with Tau-pathology; including, but not limited to, Alzheimer's disease, progressive supranuclear palsy, frontotemporal dementia, corticobasal degeneration and mild cognitive impairment.
Product: VIZAMYL 400 MBq/mL solution for injection

Primary endpoint: Detection of specific signal of 18F-RO6958948 or 18F-Flutemetamol in patients with neurodegenerative disease or healthy volunteers.
Endpoint(s): - 18F-RO6958948 or 18F-Flutemetamol PET brain:cerebellar uptake ratios measured with a priori VOI analysis in subjects with neurodegenerative disease compared to healthy volunteers, - Associations of 18F-RO6958948 or 18F-Flutemetamol brain uptake ratios measured by VOI analysis with other diagnostic methods, including CSF biomarkers, cognitive tests and MRI findings, - Regional differences in distribution of 18F-RO6958948 or 18FFlutemetamol brain uptake between different neurodegenerative disease conditions

Source: https://euclinicaltrials.eu/ctis-public/view/2024-511842-38-00